EU clinical trial 2024-511661-11-01: Long-term safety bucket trial with NVDX3, an osteogenic implant of human allogenic origin
Protocol code: NVDX3-CLN0X
Sponsor: Novadip Biosciences (Pharmaceutical company). Phase: Phase I and Phase II (Integrated)- First administration to humans. Countries: Luxembourg (ongoing, recruiting).
Therapeutic area(s): Diseases [C] - Musculoskeletal Diseases [C05]
Gender: Female, Male. Age: 18-64 years. Enrolment: 20.
Status: Ongoing, recruiting. Start date (EU): 2024-08-22. Decision date: 2024-07-10. Results received: No. Last updated: 2026-03-31.

Condition(s): Distal Radius fracture, Low grade degenerative lumbar spondylolisthesis by interbody spine fusion
Product: NVDX3

Primary endpoint: Description of all SAEs, NVDX3 related AEs and AE of special interest from screening till 120 months post- core study.

Source: https://euclinicaltrials.eu/ctis-public/view/2024-511661-11-01